EU clinical trial 2023-505898-32-00: A Phase 1/2, Open-Label, Randomized, Dose Finding and Dose Expansion Study of Gedatolisib in Combination with Darolutamide in Metastatic Castration-Resistant Prostate Cancer (mCRPC)
Protocol code: CELC-G-201
Sponsor: Celcuity Inc. (Pharmaceutical company). Phase: Phase I and Phase II (Integrated)- Other. Countries: Spain (ongoing, recruiting), France (ongoing, recruiting).
Therapeutic area(s): Diseases [C] - Male Urogenital Diseases [C12]
Gender: Male. Age: 18-64 years, 65+ years. Enrolment: 40.
Status: Ongoing, recruiting. Start date (EU): 2024-02-28. Decision date: 2024-01-23. Results received: No. Last updated: 2026-07-02.
Decision dates by country: ES: 2024-01-23, FR: 2024-01-29

Condition(s): Metastasic Castration-Resistant Prostate Cancer (mCRPC)
Product: DEXAMETHASONE, Dexamethasone 2 mg soluble tablets, BAY 1841788, Gedatolisib

Primary endpoint: Phase 1: Type, incidence, severity (as graded by National Cancer Institute [NCI] Common Terminology Criteria for Adverse Events [CTCAE] v5.0), seriousness, and relationship to study medications of adverse events (AEs) and any laboratory abnormalities, Phase 1: BOIN utility score, which includes pre-defined toxicity criteria and 6-month radiographic progression-free survival (rPFS) binary outcomes, Phase 1: Incidence of dose-limiting toxicities (DLTs) and AEs graded according to NCI CTCAE v5.0, Phase 2: rPFS rate at 6 months as measured by the Kaplan-Meier (K-M) method and assessed based on Response Evaluation Criteria in Solid Tumors (RECIST) v1.1 with modifications as specified in Prostate Cancer Working Group 3 (PCWG3) criteria
Endpoint(s): Phase 1: Gedatolisib maximum observed concentration (Cmax), area under the plasma concentration-time curve from time 0 to 24 hours (AUC0-24; Cycle 2 only), and area under the plasma concentration-time curve from 0 to last measurable concentration (AUC0-t), Phase 2: rPFS rates at 9 and 12 months and overall rPFS, Phase 2: Overall response rate (ORR): percentage of subjects who achieved an objective response (OR) based on RECIST v1.1 with modifications as specified in PCWG3 criteria for all efficacy endpoints (complete response [CR] or partial response [PR]), Phase 2: Duration of response (DOR): time from the assessment of initial response (PR or better) to death or first documented disease progression, whichever occurs first, Phase 2: Clinical benefit rate (CBR): percentage of subjects with CR, PR, or stable disease (SD) ≥24 weeks, Phase 2: Disease control rate (DCR): percentage of subjects with CR, PR, or SD, Phase 2: Overall Survival (OS) rate at 18 and 24 months, Phase 2: Type, incidence, severity (as graded by NCI CTCAE v5.0), seriousness, and relationship to study medications of AEs and any laboratory abnormalities, Phase 2: PK parameters to be estimated by population PK analysis

Source: https://euclinicaltrials.eu/ctis-public/view/2023-505898-32-00